EU clinical trial 2022-502881-25-00: A Global, Open-label Study to Investigate the Efficacy and Safety of SerpinPC in Subjects With Hemophilia B With Inhibitors (PRESent-3)
Protocol code: AP-0103
Sponsor: Apcintex Limited (Pharmaceutical company). Phase: Therapeutic exploratory (Phase II). Countries: Spain (ended), France (ended), Italy (ended), Germany (ended).
Therapeutic area(s): Diseases [C] - Hemic and Lymphatic Diseases [C15]
Gender: Male. Age: 0-17 years, 18-64 years. Enrolment: 6.
Status: Ended. Start date (EU): 2023-11-16. End date (EU): 2024-11-12. End date: 2025-02-24. Decision date: 2023-08-07. Results received: Yes. Last updated: 2024-08-06.
Decision dates by country: FR: 2023-08-07, ES: 2023-08-08, DE: 2023-08-09, IT: 2023-08-08

Condition(s): Hemophilia B
Product: SerpinPC

Primary endpoint: Study Endpoint: Treated bleeds (expressed as annualized bleeding rate [ABR]) in the observation period and during the first 24 weeks under SerpinPC
Endpoint(s): • Treated bleeds (expressed as ABR) other than those defined by the primary endpoint (eg, during the first 48 weeks), • Treated spontaneous bleeds (expressed as ABR), • Treated spontaneous joint bleeds (expressed as ABR), • All bleeds requiring treatment (expressed as ABR; ie, all bleeds that would ordinarily be treated with factor concentrate/bypass agent if therapy were available), • Total coagulation factor and/or bypass product consumption during SerpinPC treatment, • PK concentrations of SerpinPC throughout the study, • Haemophilia Quality-of-Life Questionnaire for Adults (Haem-A-QoL) Physical Health scale in subjects aged 17 to ≤65 years

Source: https://euclinicaltrials.eu/ctis-public/view/2022-502881-25-00